EU clinical trial 2024-513119-29-00: A Phase 2, Randomized, Open-Label, 24-Week Study to Assess the Pharmacodynamics, Safety, Tolerability, and Pharmacokinetics of Multiple Doses of GLM101 Administered Intravenously to Adult, Adolescent and Pediatric Participants with PMM2-CDG
Protocol code: GLM101-002
Sponsor: Glycomine Inc. (Pharmaceutical company). Phase: Therapeutic exploratory (Phase II). Countries: Spain (ended).
Therapeutic area(s): Diseases [C] - Nutritional and Metabolic Diseases [C18]
Gender: Female, Male. Age: 0-17 years, 18-64 years. Enrolment: 19.
Status: Ended. Start date (EU): 2022-12-02. End date (EU): 2025-10-02. End date: 2025-11-18. Decision date: 2024-04-22. Results received: Yes. Last updated: 2025-05-12.

Condition(s): PMM2-CDG
Product: GLM101

Primary endpoint: Change in ICARS
Endpoint(s): Evaluation of safety through the collection of safety parameters: AEs, AESIs (including Infusion-Associated Reactions), SAEs, deaths, and discontinuations due to AEs, clinical laboratory tests (hematology, chemistry, and urinalysis), ECG, vital signs, and PE findings, Concentrations of total M1P to estimate PK parameters including Cmax, Clast, tmax, tlast, t1/2, AUC0-last, AUC0-∞, AUC0-tau, %AUCex, CL, Vz, Vss, and λz

Source: https://euclinicaltrials.eu/ctis-public/view/2024-513119-29-00